EU clinical trial 2024-517751-13-01: Cannabidiol for reducing drinking in alcohol use disorder and modifying the effects of alcohol on the brain and the liver: a phase 2 clinical trial.- The CARAMEL Study
Protocol code: PHRCN2018
Sponsor: Centre Hospitalier Le Vinatier (Hospital/Clinic/Other health care facility). Phase: Therapeutic exploratory (Phase II). Countries: France (ended).
Therapeutic area(s): Psychiatry and Psychology [F] - Mental Disorders [F03]
Gender: Female, Male. Age: 18-64 years, 65+ years. Enrolment: 76.
Status: Ended. Start date (EU): 2024-12-26. End date (EU): 2026-03-16. Decision date: 2024-11-26. Results received: No. Last updated: 2024-11-26.

Condition(s): Psychiatric disorders
Product: Cannabidiol, Placebo Cannabidiol 50 mg/g

Primary endpoint: The primary endpoint will be the total consumption of alcohol (in standard-drinks, sd) in the 28 last days (week 8 to week 12) of the study, using the A-TLFB daily self-report of alcohol drinking. The difference between the total alcohol consumption during 28 days preceding the study, and the 28 last days of the study, will be compared between the two groups.
Endpoint(s): Percentages of heavy drinking days (i.e., 6 standard-drinks or more) during the study period., Difference (i.e., inclusion minus end of study) in alcohol craving scores using the OCDS., Difference (i.e., inclusion minus end of study) in alcohol use disorder scores using the AUDIT-C., Difference (i.e., inclusion minus end of study) in GGT levels., Difference (i.e., inclusion minus end of study) in CDT levels., Difference (i.e., inclusion minus end of study) in PEth levels., Difference (i.e., inclusion minus end of study) in anxiety and depression (HADS) scores., Difference (i.e., inclusion minus end of study) in self-confidence to resist, quality of life (SF12v2), stigmatization, sleep quality (PSQI) scores., Difference (i.e., inclusion minus end of study) in CAP scores using ultra-sound electrography., Difference (i.e., inclusion minus end of study) in steatosis score using MRI morphometric assessment of fat composition of the liver., Difference (i.e., inclusion minus end of study) in steatosis score using SRM assessment of lipid peaks in the liver., Brain map of difference (i.e., inclusion minus end of study) in grey matter volumes in corticostriatal-limbic circuits., Brain difference (i.e., inclusion minus end of study) in cortical thickness of insula, superior temporal gyrus, dorso-lateral prefrontal cortex and anterior cingulate cortex., Difference (i.e., inclusion minus end of study) in attentional, memory and executive functions abilities using neuropsychological testing.

Source: https://euclinicaltrials.eu/ctis-public/view/2024-517751-13-01